EU clinical trial 2024-512667-31-00: A Phase III, Randomized, Placebo-controlled, Double-blind, Multi-center, International Study of Durvalumab with Stereotactic Body Radiation Therapy (SBRT) for the Treatment of Patients with unresected Stage I/II, lymph-node negative Non-small Cell Lung Cancer (PACIFIC-4/RTOG-3515); Osimertinib cohort, Open-label, Single arm for patients with unresected stage I/II, lymph negative NSCLC harboring a sensitizing EGFR mutation
Protocol code: D9103C00001
Sponsor: AstraZeneca AB (Pharmaceutical company). Phase: Therapeutic confirmatory (Phase III). Countries: Spain (ongoing, recruitment ended), Belgium (ongoing, recruitment ended), France (ongoing, recruitment ended), Poland (ongoing, recruitment ended), Netherlands (ongoing, recruitment ended), Germany (ongoing, recruitment ended), Italy (ongoing, recruitment ended), Greece (ongoing, recruitment ended).
Therapeutic area(s): Diseases [C] - Neoplasms [C04]
Gender: Female, Male. Age: 18-64 years, 65+ years. Enrolment: 148.
Status: Ongoing, recruitment ended. Start date (EU): 2019-04-23. Decision date: 2024-06-06. Results received: No. Last updated: 2026-07-06.
Decision dates by country: DE: 2024-06-07, NL: 2024-06-06, IT: 2024-06-24, ES: 2024-06-06, GR: 2024-07-22, FR: 2024-06-06, BE: 2024-06-07, PL: 2024-06-17

Condition(s): Main cohort: Patients with unresected Stage I/II, lymph-node negative Non-small Cell Lung Cancer; Osimertinib cohort: Open-label, Single arm for patients with unresected stage I/II, lymph done negative NSCLC harboring a sensitizing EGFR mutation
Product: INFLIXIMAB, IMFINZI 50 mg/mL concentrate for solution for infusion., TAGRISSO 80 mg film-coated tablets, GLUCOSE, MYCOPHENOLATE MOFETIL, TAGRISSO 40 mg film-coated tablets

Primary endpoint: Applicable to main cohort: PFS in patients with subset of T1 to T3N0M0 by BICR, Applicable to osimertinib cohort: 4-years PFS by ICR using RECIST 1.1
Endpoint(s): Applicable to main cohort: PFS in patients with T1 to T3N0M0 NSCLC; Overall Survival; PFS24, TTP, and TTDM using BICR assessments according to RECIST 1.1; PFS2 using local assessment; PK of durvalumab in serum; Presence of ADA for durvalumab; EORTC QLQ-C30: Change in symptoms, functioning, and global health status/quality of life; Safety and tolerability:AEs, physical examinations, vital signs, electrocardiograms, and laboratory findings, Applicable to osimertinib cohort: AEs (graded by CTCAE version 5); Laboratory studies: chemistry, hematology, and urinalysis; Clinical evaluations; ECG parametres; LVEF; WHO performance status; PFS using RECIST 1.1; OS; Site(s) of disease progression; Time to CNS progression; TTP; PFS2

Source: https://euclinicaltrials.eu/ctis-public/view/2024-512667-31-00